EU clinical trial 2022-500027-76-00: METIMMOX-2: Metastatic pMMR/MSS Colorectal Cancer – Shaping Anti-Tumor Immunity by Oxaliplatin
Protocol code: METIMMOX-2
Sponsor: Akershus University Hospital (Hospital/Clinic/Other health care facility). Phase: Therapeutic exploratory (Phase II). Countries: Norway (ongoing, recruitment ended).
Therapeutic area(s): Diseases [C] - Neoplasms [C04]
Gender: Female, Male. Age: 18-64 years, 65+ years. Enrolment: 40.
Status: Ongoing, recruitment ended. Start date (EU): 2022-10-05. Decision date: 2022-05-30. Results received: No. Last updated: 2025-05-28.

Condition(s): Colorectal cancer
Product: Adrenalin Aguettant 1 mg/ml injeksjonsvæske, oppløsning i ferdigfylt sprøyte, Kalsiumfolinat Pfizer 10 mg/ml injeksjonsvæske, oppløsning, OPDIVO 10 mg/mL concentrate for solution for infusion., Dexamethasone Krka 4 mg tabletter, Solu-Cortef 250 mg pulver og væske til injeksjonsvæske, oppløsning i tokammerhetteglass, Fluorouracil Accord 50 mg/ml injeksjons-/infusjonsvæske, oppløsning, Ondansetron Bluefish 8 mg tabletter, filmdrasjerte, Paracet 1 g tabletter, Metoclopramide Accord 10 mg tabletter, Oxaliplatin Fresenius Kabi 5 mg/ml konsentrat til infusjonsvæske, oppløsning

Primary endpoint: PFS: radiologic assessment following every 2 cycles each of FLOX and nivolumab, according to RECIST v1.1 and iRECIST
Endpoint(s): Safety: incidence of adverse events, as reported according to CTCAE v5.0, recorded on onboing basis and summarized at every visit., Tolerability: adverse event grading, as assessed by CTCAE v5.0, recorded on onboing basis and summarized at every visit., Objective response rate: the percentage of patients with a confirmed complete or partial response., Duration of response: the time from the first documentation of a complete or partial response to disease progression on active therapy., Secondary surgical curative-intent resection rate: the percentage of patients with a confirmed resection of metastatic disease with microscopically free margin (R0)., Overall survival: the time from study enrollment to death of any cause.

Source: https://euclinicaltrials.eu/ctis-public/view/2022-500027-76-00